EU clinical trial 2024-515260-31-00: proMoting Effective Renoprotection in Cardiac sURgery patients by Inhibition of SGLT-2
Sponsor: Stichting Amsterdam UMC (Hospital/Clinic/Other health care facility). Phase: Therapeutic use (Phase IV). Countries: Netherlands (ended).
Therapeutic area(s): Analytical, Diagnostic and Therapeutic Techniques and Equipment [E] - Therapeutics [E02]
Gender: Female, Male. Age: 18-64 years, 65+ years. Enrolment: 784.
Status: Ended. Start date (EU): 2023-06-09. End date (EU): 2025-05-12. Decision date: 2024-06-25. Results received: Yes. Last updated: 2024-10-21.

Condition(s): AKI
Product: Forxiga 10 mg film-coated tablets

Primary endpoint: Incidence of AKI within 7 days after surgery, satisfying KDIGO criteria.
Endpoint(s): Stage 3 AKI according to KDIGO criteria, Postoperative maximum change of eGFR compared to the baseline eGFR, De novo postoperative atrial fibrillation, registered on a 12-lead ECG, LoS-ICU: Length of Stay in the Intensive Care Unit, measured in days, LoS-Hos: Length of Stay in Hospital, measured in days, MAKE: Major Adverse Kidney Events. Composite endpoint of death, new dialysis, and worsened renal function, MACE: Major Adverse Cardiovascular Events. Composite endpoint of cardiovascular death, nonfatal myocardial infarction (MI), nonfatal ischaemic cerebral vascular accident (iCVA) and hospitalization for heart failure, Patient reported quality of recovery (QoR), according to the following three questionnaires: o DAH30: Days at Home in first 30 days o WHO-DAS 2.0: World Health Organisation Disability Assessment Schedule 2.0 o EQ5D5L: 5 level EuroQol 5D questionnaire: a standardised measure of health status developed by the EuroQol Group to provide a simple, generic measure of health for clinical and economic appraisal, Safety outcomes: genital mycotic infections, diabetic keto-acidosis, and hypoglycaemia, in addition to incidence of postoperative complications and Serious Adverse Events (SAEs), Healthcare costs and productivity costs will be objectified to weigh cost-effectiveness, using the following two questionnaires: o iPCQ: IMTA (Institute for Medical Technology Assessment) Productivity Cost Questionnaire. o IMCQ: IMTA (Institute for Medical Technology Assessment) Medical Consumption Questionnaire., Peri-operative glucose measurements (routinely measured in clinical setting): average daily glucose, incidence of hypoglycaemia (blood glucose < 4 mmol/l) and hyperglycaemia (blood glucose > 10 mmol/l), Peri-operative heamodynamic vital signs (routinely measured in clinical setting)., Postoperative of cardiac function (echocardiography and cardiac biomarkers) routinely carried out in clinical practice, Urine oxygenation measured with an oxygen sensor placed in the urinary catheter: mean intraoperative urine oxygenation, change from baseline and mean postoperative urine oxygenation. Frequency and duration of monitor interruptions. Correlation in time between deprived urine oxygenation and current AKI markers.

Source: https://euclinicaltrials.eu/ctis-public/view/2024-515260-31-00